EU clinical trial 2024-512757-24-00: LANdiolol MIcrocirculatory effects during Septic chOc (MILANOS)
Protocol code: APHP191047
Sponsor: Assistance Publique Hopitaux De Paris (Hospital/Clinic/Other health care facility). Phase: Therapeutic confirmatory (Phase III). Countries: France (ongoing, recruiting).
Therapeutic area(s): Diseases [C] - Cardiovascular Diseases [C14]; Diseases [C] - Bacterial Infections and Mycoses [C01]
Gender: Female, Male. Age: 18-64 years, 65+ years. Enrolment: 44.
Status: Ongoing, recruiting. Start date (EU): 2022-07-18. Decision date: 2024-10-08. Results received: No. Last updated: 2025-07-18.

Condition(s): Patients with microcirculatory abnormalities during septic shock
Product: RAPIBLOC 300 mg, poudre pour solution pour perfusion

Primary endpoint: Variation (%) in microcirculatory vascular reactivity (T2-T0/T0x100).
Endpoint(s): Variation (%) in cardiac output (echocardiography), Variation (%) in clinical perfusion parameters between T0 and T2: mottling score, skin recoloration time, hourly diuresis, Variation (%) in arterial lactate clearance between T0 and T2, Variation (%) in systemic and endothelial inflammation parameters between T0 and T2 : Plasma cytokines (Procartaplex), VCAM-1 soluble, Soluble Endocan

Source: https://euclinicaltrials.eu/ctis-public/view/2024-512757-24-00